EU clinical trial 2023-509610-11-00: Hyperbaric Oxygen Therapy in Hamstring injury (HOTHAM) trial
Sponsor: Amsterdam UMC (Hospital/Clinic/Other health care facility). Phase: Therapeutic confirmatory (Phase III). Countries: Netherlands (ongoing, recruiting).
Therapeutic area(s): Diseases [C] - Musculoskeletal Diseases [C05]
Gender: Female, Male. Age: 18-64 years. Enrolment: 50.
Status: Ongoing, recruiting. Start date (EU): 2024-10-27. Decision date: 2024-04-22. Results received: No. Last updated: 2024-04-22.

Condition(s): Acute hamstring injury
Product: Conoxia, 100% v/v, medicinaal gas, samengeperst, Conoxia® Vloeibaar, 100% v/v, medicinaal gas, cryogeen

Primary endpoint: Time needed to return to play (days) for athletes or time needed to return to full unrestricted duty (days) for military personnel.
Endpoint(s): Patient reported hamstring scores: Tenger activity score, Functional assessment scale for acute hamstring injuries and psychological readiness., Maximum and mean pain scores (0-10) assessed with the visual analog scale, at injury, at rest and during sprinting, Physical examination including: - Palpation: Location and dimension of painful area/lesion, presence of hematoma or – swelling o Pain with isometric contraction against resistance - Hamstring flexibility tests: Passive straight leg raise, Active knee extension test. - Hamstring isometric strength (Hand hold dynamometer), MRI derived parameters: Aspect of the injury on T1 and T2- weighted images scored by a radiologist using a standardized form., Number of re-injury at 2- and 12 months following return to play/ return to full unrestricted duty., Number of (serious)adverse events from inclusion to ≤7 days following the last hyperbaric oxygen treatment session.

Source: https://euclinicaltrials.eu/ctis-public/view/2023-509610-11-00